EU clinical trial 2024-516570-30-00: A PRECISION MEDICINE RANDOMIZED TRIAL FOR PATIENTS WITH RELAPSED OR REFRACTORY T-CELL ACUTE LYMPHOBLASTIC LEUKEMIA BASED ON A FUNCTIONAL APPROACH. ALL-TARGET TRIAL
Sponsor: Centre Hospitalier De Versailles (Hospital/Clinic/Other health care facility). Phase: Therapeutic exploratory (Phase II). Countries: Germany (authorised, recruitment pending), France (authorised, recruitment pending), Czechia (authorised, recruitment pending), Netherlands (authorised, recruitment pending), Spain (authorised, recruitment pending).
Therapeutic area(s): Diseases [C] - Hemic and Lymphatic Diseases [C15]
Gender: Female, Male. Age: 0-17 years, 18-64 years, 65+ years. Enrolment: 86.
Status: Authorised, recruitment pending. Decision date: 2026-05-29. Results received: No. Last updated: 2026-06-08.
Decision dates by country: CZ: 2026-06-01, FR: 2026-06-03, DE: 2026-06-03, ES: 2026-06-03, NL: 2026-05-29

Condition(s): Relapsed/refractory T-cell Acute Lymphoblastic Leukemia
Product: XELJANZ 5 mg film-coated tablets, Enrylaze 10 mg/0.5mL, solution for injection/infusion, Venetoclax, Venetoclax, Azacitidine Mylan 25 mg/mL powder for suspension for injection, Venetoclax, Afinitor 5 mg tablets

Primary endpoint: Hematological remission rate, which is a composite outcome (CRc), defined as the best response observed within 3 months post randomization, either complete remission (CR) or remission without complete hematological recovery (CRi).
Endpoint(s): 1. Hematological response rate (HR) defined as complete remission (CR), remission without complete hematological recovery (CRi) and partial response (PR) by 3 months post randomization., 2. Overall survival, defined as the time from randomization up to death, whatever the cause, 3. Stable disease by 3 months, 4. Duration of response, 5. Event free survival, defined as the time from randomization up to relapse or death, whichever occurred first, 6. Relapse free survival, defined as the time from response up to relapse or death, 7. Adverse events and cumulative incidence of adverse events (treatment duration + 1 mois), 8. Response per treatment combination by 3 and 6 months, 9. Bridge to transplant, bridge to CART-cell, 10. Minimal residual disease at 3 months in responding patients, 11. Quality of life (HM-PRO & HADS) questionnaires monthly up to 3 months, 12. Mechanisms of resistance to therapies, 13. Post-hoc analysis of TTO allocation

Source: https://euclinicaltrials.eu/ctis-public/view/2024-516570-30-00